EU clinical trial 2023-508539-30-00: A Phase 2/3 Multicenter, Randomized, Double-Blind, Placebo-Controlled, Study to Evaluate the Efficacy, Safety and Tolerability of BHV-7000 in Subjects with Refractory Focal Onset Epilepsy
Protocol code: BHV7000-302
Sponsor: Biohaven Therapeutics Ltd. (Pharmaceutical company). Phase: Therapeutic exploratory (Phase II). Countries: Belgium (ongoing, recruiting), Hungary (ongoing, recruiting), Slovenia (ongoing, recruiting), Austria (ongoing, recruiting), Netherlands (ongoing, recruiting), France (ongoing, recruiting), Czechia (ongoing, recruiting), Croatia (ended), Poland (ongoing, recruiting).
Therapeutic area(s): Diseases [C] - Nervous System Diseases [C10]
Gender: Female, Male. Age: 18-64 years, 65+ years. Enrolment: 194.
Start date (EU): 2024-10-10. Decision date: 2024-07-26. Results received: No. Last updated: 2026-03-20.
Decision dates by country: HU: 2024-07-30, AT: 2024-07-31, BE: 2024-07-29, NL: 2024-07-29, SI: 2024-07-29, HR: 2024-07-31, CZ: 2024-07-30, PL: 2024-09-11, FR: 2024-07-26

Condition(s): Refractory Focal Onset Epilepsy
Product: BHV-7000, BHV-7000, Placebo for BHV-7000

Primary endpoint: Part A: Safety is assessed by the number of unique subjects with deaths, SAEs, AEs leading to discontinuation, moderate and severe AEs and grade 3 and 4 laboratory abnormalities. Part B: Proportion of subjects with at least a 50% reduction in 28-day average seizure frequency over the course of the DBP compared to the OP.
Endpoint(s): Part A: N/A Part B: - Change in log-transformed 28-day adjusted seizure frequency from OP over the 12-week DBP. -Change in log-transformed 28-day adjusted seizure frequency from OP over the first month of the DBP., Part B: - Proportion of subjects with at least a 75% reduction in 28-day average seizure frequency over the course of the DBP compared to the OP. -Proportion of subjects that are seizure free during the DBP. -Change in log-transformed 7-day adjusted seizure frequency from OP over the first week of the DBP., Part B: - Proportion of subjects at week 12 with PGI-C response of "minimally improved", "much improved", or "very much improved". -Safety is assessed by the number of unique subjects with deaths, SAEs, AEs leading to discontinuation, moderate and severe AEs and grade 3 and 4 laboratory abnormalities.

Source: https://euclinicaltrials.eu/ctis-public/view/2023-508539-30-00